EU clinical trial 2024-512589-32-00: ION582-CS1: A Study to Evaluate the Safety, Tolerability, Pharmacokinetics and Pharmacodynamics of Intrathecally Administered ION582 in Patients with Angelman Syndrome
Protocol code: ION582CS1
Sponsor: Ionis Pharmaceuticals Inc. (Pharmaceutical company). Phase: Phase I and Phase II (Integrated)- First administration to humans. Countries: France (ongoing, recruiting), Italy (ongoing, recruiting).
Therapeutic area(s): Diseases [C] - Nervous System Diseases [C10]
Gender: Female, Male. Age: 0-17 years, 18-64 years. Enrolment: 8.
Status: Ongoing, recruiting. Start date (EU): 2024-09-16. Decision date: 2024-08-28. Results received: No. Last updated: 2026-07-28.
Decision dates by country: FR: 2024-08-28, IT: 2024-09-16

Condition(s): Angelman syndrome
Product: ION582

Primary endpoint: To evaluate the safety and tolerability of single and multiple doses of ION582 (incidence, severity, and dose-relationship of adverse effects and changes in the laboratory parameters)
Endpoint(s): Maximum Observed Plasma Concentration of ION582, Time to Reach Maximal Plasma Concentration of ION582, Plasma Elimination Half-Life of ION582, Concentration ION582 in cerebrospinal fluid

Source: https://euclinicaltrials.eu/ctis-public/view/2024-512589-32-00